EU clinical trial 2024-514090-21-00: Prospective, multicenter, randomized, double-blind, placebo-controlled, efficacy and safety clinical trial with subcutaneous immunotherapy in patients with rhinitis/rhinoconjunctivitis with or without mild to moderate asthma sensitized to Dermatophagoides pteronyssinus and/or Dermatophagoides farinae
Protocol code: MM09-SIT-023
Sponsor: Inmunotek S.L. (Pharmaceutical company). Phase: Therapeutic confirmatory (Phase III). Countries: Spain (ended).
Therapeutic area(s): Diseases [C] - Immune System Diseases [C20]
Gender: Female, Male. Age: 0-17 years, 18-64 years, 65+ years. Enrolment: 150.
Status: Ended. Start date (EU): 2020-08-05. End date (EU): 2026-04-27. Decision date: 2024-08-16. Results received: No. Last updated: 2026-02-17.

Condition(s): Aetiological treatment of moderate - severe intermittent or persistent allergic rhinitis/rhinoconjunctivitis with or without controlled mild - moderate intermittent or persistent allergic asthma
Product: Clustoid MM09, The same as active product, Clustoid MM09

Primary endpoint: To evaluate the efficacy of allergen extracts in subjects with moderate-severe intermittent or persistent rhinitis/rhinoconjunctivitis with or without controlled mild to moderate intermittent or persistent asthma sensitised to Dermatophagoides pteronyssinus and/or Dermatophagoides farinae, aged 12-65 years, by assessing the combined symptom score and medication intake, between baseline and end of the trial.
Endpoint(s): Rhinitis/rhinoconjunctivitis symptom score (RSS), Rhinitis/rhinoconjunctivitis medication score (RMS), Asthma combined symptom and medication score (ACSMS), Asthma symptom score (ASS), Asthma Medication Score (AMS), Asthma and Rhinitis/Rhinoconjunctivitis Symptom Score (ARSS), Asthma and rhinitis/rhinoconjunctivitis medication score (ARMS), Combined symptom and medication score for asthma and rhinitis/rhinoconjunctivitis (ARCSMS), Symptom-free days and medication-free days for rhinitis/rhinoconjunctivitis and for asthma, Time since first onset of asthma exacerbation, number, severity, and duration of asthma exacerbations, Quality of life using the ESPRINT-15 questionnaire in rhinitis and asthma monitoring using the asthma symptom control questionnaire (GINA), Visual Analogue Scale (VAS), Serum immunological parameters (total IgE, specific IgE and specific IgG4), Consumption of health resources, Safety of specific immunotherapy (Overall rate, severity, and ratio of any adverse events (AEs) per administration and per subject and assessment of administration site reactions, systemic reactions and any concomitant medication administered for the treatment of AEs)

Source: https://euclinicaltrials.eu/ctis-public/view/2024-514090-21-00